EU clinical trial 2023-505361-86-00: Effect of infLuenza vaccInation after Myocardial INfArction on cardiac inflammaTory responsE - a randomized, double-blind, placebo-controlled, trial (ELIMINATE trial)
Protocol code: ELIMINATE-2024
Sponsor: Region Oerebro Laen (Hospital/Clinic/Other health care facility). Phase: Therapeutic use (Phase IV). Countries: Sweden (ongoing, recruiting), Denmark (ongoing, recruiting).
Therapeutic area(s): Diseases [C] - Cardiovascular Diseases [C14]
Gender: Female, Male. Age: 18-64 years, 65+ years. Enrolment: 90.
Status: Ongoing, recruiting. Start date (EU): 2024-04-12. Decision date: 2023-11-24. Results received: No. Last updated: 2025-04-29.
Decision dates by country: SE: 2023-11-24, DK: 2025-04-29

Condition(s): Myocardial infarction
Product: VaxigripTetra, injektionsvätska, suspension i förfylld spruta Fyrvalent influensavaccin (spjälkat virus, inaktiverat), Natriumklorid B. Braun 9 mg/ml infusionsvätska, lösning

Primary endpoint: Change from baseline in pericoronary adipose tissue (PCAT) density (right coronary artery), a marker of coronary artery inflammation measured by CCTA, at week 8.
Endpoint(s): Change from baseline in the average PCAT density of the whole coronary tree (main epicardial arteries ≥2mm), Change from baseline in the perivascular adipose tissue density of the ascending aorta, Differences in cytokine and chemokine profiles (including IL-1β, TNF-α, IL-2r, IL-6), and other markers of systemic inflammation, (ferritin and high sensitivity CRP) at baseline and 8 weeks follow up, Cardiac biomarkers (troponin-I, N-terminal pro-B-type natriuretic peptide) at 8 weeks follow up, Exploratory endpoints: Differences in myeloid, T- and B cell subpopulations, their activation status and their gene expression signatures, measured by mass cytometry and single-cell RNA sequencing, and differences in blood proteome, from baseline to 8 weeks.

Source: https://euclinicaltrials.eu/ctis-public/view/2023-505361-86-00